EU clinical trial 2023-503345-59-00: Single dose, open-label, laboratory blinded, randomised, 2-treatment, 2-period, 2-sequence, crossover bioequivalence study of test product Perampanel 12 mg film-coated tablets versus reference product Fycompa 12 mg film-coated tablets (Eisai GmbH) in healthy adult male and female subjects under fasting conditions.
Protocol code: CFA-1031-1-22
Sponsor: Laboratorios Cinfa S.A. (Pharmaceutical company). Phase: Human Pharmacology (Phase I)- Bioequivalence Study. Countries: Czechia (ended).
Therapeutic area(s): Diseases [C] - Nervous System Diseases [C10]
Gender: Female, Male. Age: 18-64 years. Enrolment: 36.
Status: Ended. Start date (EU): 2023-05-23. End date (EU): 2023-08-15. Decision date: 2023-05-04. Results received: Yes. Last updated: 2023-05-04.

Condition(s): Not applicable (submitted trial is a bioequivalence study in Healthy Subjects)
Product: Perampanel 12 mg film-coated tablets, Fycompa 12 mg film-coated tablets

Primary endpoint: Cmax and AUC(0-72h) – as per truncated design; 90% confidence intervals for the T/R ratio of LSM for perampanel based on ln-transformed data will be calculated and compared with acceptance limits: AUC(0-72h) 80.00 – 125.00%, Cmax 80.00 – 125.00%.
Endpoint(s): tmax

Source: https://euclinicaltrials.eu/ctis-public/view/2023-503345-59-00